EU clinical trial 2024-519320-24-00: A Phase I/IIa study to assess the safety and biological activity of TdT-3, an autologous TCR T-cell therapy targeting TdT, in HLA-A*02:01+ patients aged ≥1 year with relapsed or refractory TdT+ acute leukemia or lymphoblastic lymphoma.
Protocol code: TDT-TCR01
Sponsor: Oslo University Hospital HF (Hospital/Clinic/Other health care facility). Phase: Phase I and Phase II (Integrated)- First administration to humans. Countries: Norway (authorised, recruitment pending).
Therapeutic area(s): Diseases [C] - Hemic and Lymphatic Diseases [C15]
Gender: Female, Male. Age: 0-17 years, 18-64 years, 65+ years. Enrolment: 15.
Status: Authorised, recruitment pending. Decision date: 2025-06-26. Results received: No. Last updated: 2025-12-19.

Condition(s): Acute lymphoblastic leukemia (ALL) or lymphoblastic lymphoma (LBL)
Product: TdT-3 non-weight based, TdT-3

Primary endpoint: Safety: Type, incidence and severity of Dose Limiting Toxicities (DLTs) from infusion until day +28., Incidence and severity of adverse events, serious adverse events, laboratory abnormalities, changes in vital signs, and changes in physical examination following infusion of TdT-3, recorded, and graded according to CTCAE version 5.0 at fractionated dose levels, Maximum Tolerated Dose (MTD), defined as the dose level with an estimated DLT probability closest to the target DLT probability of 25%, or the highest administered dose if the MTD is not achieved, Feasibility: Rate of successful provision (i.e., manufacture, release and shipment) of TdT-3 within a clinically relevant time frame (intent-to-treat)
Endpoint(s): Quantification of TdT-3 in Peripheral Blood (PB), BM, Cerebrospinal Fluid (CSF) in vivo using TdT-3 specific immunoassays and transgene detection, Changes in levels of soluble immune mediators in PB, BM and CSF from baseline until day +28 after TdT-3 treatment, Identification of cellular composition, T cell phenotype distribution and functionality of the TdT-3 infusion product, Rate of successful manufacturing of TdT 3 of at least 80% of the intended dose level, Preliminary efficacy of TdT-3 in B-/T-ALL patients: • Proportion of participants achieving a response at 1- or 3-months post infusion defined as - Complete Remission (CR) or CR with incomplete blood count recovery (CRi) (only participants with >5% BM blasts prior to TdT-3 infusion are evaluable) and - MRD negativity in the bone marrow (defined as MRD<0.01% by flowcytometry or leukemia-specific PCR) (only participants with >0.01% BM blasts prior to TdT-3 infusion are evaluable), Duration of Response (DOR), Disease-free Survival (DFS), event-free survival (EFS) and Overall Survival (OS) at 6 months, 1- and 2-years post TdT 3 infusion, Proportion of participants proceeding to SCT for any reason, including for recurrence of disease, consolidation of response or immunological rescue, Preliminary efficacy of TdT-3 in B-/T-LBL: • Overall response rate (ORR) (CR and PR) within 3 months of infusion • DOR, DFS, EFS and OS at 1- and 2-years post TdT-3 infusion, Change of the Patient-reported Outcomes (PRO) and Health-related Quality of life (HRQoL) from baseline to day 28, and 3-, 6-, 9- and 12- and 24-months post infusion for the group and the individual patient, Exploratory endpoint: Correlation between TdT and HLA-A*02:01 expression and/or tumor burden and TdT-3 efficacy, persistence, and toxicity, Exploratory endpoint: Rate of relapses after TdT-3 treatment • with or without loss of TdT and/or HLA-A*02:01 expression, Exploratory endpoint: Quantification of thymic output and circulating immune cell subsets after TdT 3 infusion to assess B- and T-cell maturation, phenotype and T-cell receptor diversity, Exploratory enpoint: Determine the presence of anti-TdT-3 antibodies before and after TdT-3 treatment, Exploratory endpoint: Evaluate dose-exposure-response relationships, Exploratory endpoint: Explore associations between PK, PD, toxicity and efficacy of TdT-3, Exploratory endpoint: Explore associations between participants’ baseline disease characteristics including tumor genetics/genomic profiles, toxicity and efficacy outcomes

Source: https://euclinicaltrials.eu/ctis-public/view/2024-519320-24-00